EU clinical trial 2024-513483-26-00: Phase 3, Multicenter, Randomized, Double-Masked, Placebo-Controlled Study to Evaluate the Safety and Efficacy of Tinlarebant in the Treatment of Stargardt Disease in Adolescent Subjects
Protocol code: LBS-008-CT03
Sponsor: Belite Bio Inc. (Pharmaceutical company). Phase: Therapeutic confirmatory (Phase III). Countries: France (ended), Netherlands (ended), Belgium (ended), Germany (ended).
Therapeutic area(s): Diseases [C] - Eye Diseases [C11]
Gender: Female, Male. Age: 0-17 years, 18-64 years. Enrolment: 9.
Status: Ended. Start date (EU): 2022-11-28. End date (EU): 2025-09-10. End date: 2025-09-11. Decision date: 2024-05-15. Results received: Yes. Last updated: 2026-01-07.
Decision dates by country: DE: 2024-05-16, NL: 2024-05-15, BE: 2024-05-17, FR: 2024-06-07

Condition(s): Stargardt Disease
Product: Tinlarebant 5 mg´s matching Placebo, LBS-008

Primary endpoint: The primary efficacy endpoint is the annualized rate of lesion growth in the aggregate area of atrophy (definitely decreased autofluorescence [DDAF]) from baseline as assessed by FAF photography. The primary assessment of efficacy will be performed at Month 25.
Endpoint(s): · Annualized rate of lesion growth in total area of decreased autofluorescence (DAF; the sum of DDAF and questionably decreased autofluorescence [QDAF]) from baseline by FAF photography, · Change in photoreceptor morphology (EZ defect area) from baseline to post baseline assessments (assessed by SD-OCT), · Change in BCVA measured by the ETDRS method under standard luminance from baseline to post baseline assessments, · Change in RBP4 levels from baseline to Month 25, · Correlation between the change in RBP4 level and the change of aggregate lesion size from baseline to Month 25, Physical examination, vital signs measurement, ECG, ophthalmic examination, clinical laboratory tests (including serum chemistry and hematology panels, urinalysis, and pregnancy tests on all female subjects), retinol chemistries (plasma retinol, plasma RBP4), visual function questionnaire, measurement of intraocular pressure (IOP), dark adaptation test, dilated funduscopy, contrast sensitivity assessment of AEs, and monitoring of concomitant medications.

Source: https://euclinicaltrials.eu/ctis-public/view/2024-513483-26-00